EU clinical trial 2024-512468-71-00: A phase I/IIa, prospective, mono-center, randomized, open labeled, controlled study to assess the safety and efficacy of applying Iloprost locally in the fracture site to promote bone healing in patients with proximal humeral fracture - ILOBONE
Protocol code: Ilobone (SIFU17)
Sponsor: Charite Universitaetsmedizin Berlin KöR (Hospital/Clinic/Other health care facility). Phase: Phase I and Phase II (Integrated)- Other. Countries: Germany (ended).
Therapeutic area(s): Phenomena and Processes [G] - Musculoskeletal and Neural Physiological Phenomena [G11]
Gender: Female, Male. Age: 18-64 years, 65+ years. Enrolment: 30.
Status: Ended. Start date (EU): 2022-09-21. End date (EU): 2026-02-12. Decision date: 2024-11-04. Results received: No. Last updated: 2024-11-04.

Condition(s): Proximal humeral fracture
Product: Ilomedin® 20 μg/1 ml, Konzentrat zur Herstellung einer Infusionslösung

Primary endpoint: Identification of any noxious response or toxicity that has a causal relationship to the treatment. Toxicity shall be graded according to the National Cancer Institute Common Terminology Criteria for Adverse Events (NCI-CTCAE).
Endpoint(s): Rate of humeral head necrosis, Humeral head shaft angle, Pain assessment (VAS), Quality of life (EQ-5D), Constant-Murley Score (CMS), Disabilities of the Arm, Shoulder and Hand score (DASH)

Source: https://euclinicaltrials.eu/ctis-public/view/2024-512468-71-00